EU clinical trial 2024-516403-16-00: Intravenous Immunoglobulin plus oral prednisone or high-dose dexamethasone, for adults with immune thrombocytopenia (ITP) with moderate and severe bleeding: a randomized, multicentre trial (IVIORDEX)
Protocol code: APHP200017
Sponsor: Assistance Publique Hopitaux De Paris (Hospital/Clinic/Other health care facility). Phase: Therapeutic confirmatory (Phase III). Countries: France (ongoing, recruitment ended).
Therapeutic area(s): Diseases [C] - Hemic and Lymphatic Diseases [C15]
Gender: Female, Male. Age: 18-64 years, 65+ years. Enrolment: 272.
Status: Ongoing, recruitment ended. Start date (EU): 2022-04-07. Decision date: 2024-11-13. Results received: No. Last updated: 2025-05-27.

Condition(s): Adult patients with immune thrombocytopenia (ITP) with mild to severe bleeding manifestations
Product: Neofordex 40 mg tablets, IMMUNOGLOBULINS, NORMAL HUMAN, FOR INTRAVASCULAR ADM., PREDNISONE

Primary endpoint: Time (in days) to achieve an initial response (R) within 5 days. - Initial response (R) will be defined according to international guidelines (5) as a platelet count ≥ 30x109/L with at least a doubling of the baseline value in the absence of new bleeding and absence of the use of any other ITP directed therapies (other than the one of the treatment arm)
Endpoint(s): Time (in days) to achieve an initial complete response (CR) in both arms (defined by a platelet count > 100 x 109/L in the absence use of any other ITP directed therapies between Day 1 and Day 5) in the two arms., Duration in time (in days) of overall response from Day 1 to the end of the study (6 months) in the two arms., Proportion of early (before day 5) treatment switches across arms, Number of new bleeding manifestations between Day 1 and Day 5 in two arms. Bleeding manifestations will be assessed the score reported by Khellaf et al. without taking into account the age of the patient., Rates of response (R) and complete response (CR) at 28 days, and 6 months in the two arms., Number of bleeding manifestations between Day 5 and Day 28 in the two arms., Number of days of hospitalization between Day 1 and Day 28 in the two arms., Number of adverse events in the two arms., Incremental (decremental) cost effectiveness ratio expressed in cost per responder at 6 months, Comparison of the number of responders, and outcome at 6 months in patients with positive and negative anti-platelets antibodies in the two arms.

Source: https://euclinicaltrials.eu/ctis-public/view/2024-516403-16-00